EU clinical trial 2023-504943-15-00: HIsTological and CLinical effects of Imipramine in the treatment of patients with cancer over-expressing Fascin1. (HITCLIF)
Protocol code: IMIB-HTF-2021-01
Sponsor: Fundacion Para La Formacion E Investigacion Sanitaria De La Region De Murcia (Educational Institution). Phase: Therapeutic exploratory (Phase II). Countries: Spain (ongoing, recruiting).
Therapeutic area(s): Diseases [C] - Hormonal diseases [C19]; Diseases [C] - Digestive System Diseases [C06]
Gender: Female, Male. Age: 18-64 years, 65+ years. Enrolment: 180.
Status: Ongoing, recruiting. Start date (EU): 2022-08-19. Decision date: 2023-08-07. Results received: No. Last updated: 2025-06-13.

Condition(s): Cancer(colon cancer stage II-III, rectal cancer, and breast cancer)over-expressing Fascin1
Product: Sucrose c.s. and lactose c.s., TOFRANIL 50 mg comprimidos recubiertos

Primary endpoint: Changes in the invading front associated with the epithelial-mesenchymal transition quantified as measurement of tumor budding, cytoplasmic pseudofragments, pattern of tumor invasion, and characteristics of the immune infiltrate (intra- and peritumoral lymphocytes, characterization of Crohn-like response macrophages).
Endpoint(s): Evaluation of plasma quantification of tumor DNA copies and the expression of serum and tissue fascina1 in the surgical resection piece.

Source: https://euclinicaltrials.eu/ctis-public/view/2023-504943-15-00